EU clinical trial 2024-519799-25-00: efficacy and safety of the use of regulatory T cells in immune hyperactivation in patients with COVID-19 and/or acute respiratory distress syndrome
Protocol code: FIBHGM-ECNC003-2021
Sponsor: Fundacion Para La Investigacion Biomedica Del Hospital Gregorio Maranon (Hospital/Clinic/Other health care facility). Phase: Phase I and Phase II (Integrated)- First administration to humans. Countries: Spain (authorised, recruitment pending).
Therapeutic area(s): Diseases [C] - Immune System Diseases [C20]
Gender: Female, Male. Age: 18-64 years. Enrolment: 24.
Status: Authorised, recruitment pending. Decision date: 2025-01-30. Results received: No. Last updated: 2026-04-21.

Condition(s): immune hyperactivation in COVID-19 patients and/or acute respiratory distress syndrome

Source: https://euclinicaltrials.eu/ctis-public/view/2024-519799-25-00